EU clinical trial 2024-515074-26-00: A study to evaluate the safety and tolerability of single ascending doses of AGMB-101 in healthy participants (Part A) and patients with liver cirrhosis (Part B).
Protocol code: AGMB101-01-CL-102
Sponsor: AgomAb Therapeutics (Pharmaceutical company). Phase: Human Pharmacology (Phase I)- First administration to humans. Countries: Belgium (authorised, recruitment pending).
Therapeutic area(s): Diseases [C] - Digestive System Diseases [C06]
Gender: Female, Male. Age: 18-64 years, 65+ years. Enrolment: 64.
Status: Authorised, recruitment pending. Decision date: 2025-02-21. Results received: No. Last updated: 2025-02-27.
Decision dates by country: BE: 2025-02-27

Condition(s): liver cirrhosis

Source: https://euclinicaltrials.eu/ctis-public/view/2024-515074-26-00